EU clinical trial 2024-517391-38-00: SIROLIMUS VERSUS MYCOPHENOLATE MOFETIL IN SIMULTANEOUS PANCREAS AND KIDNEY TRANSPLANTATION TO EVALUATE THE RISK OF HERNIA
Protocol code: SIMA SPK 01
Sponsor: Institute For Clinical And Experimental Medicine (Hospital/Clinic/Other health care facility). Phase: Therapeutic use (Phase IV). Countries: Czechia (ongoing, recruiting).
Therapeutic area(s): Analytical,Diagnostic,Therapeutic Techniques and Equipment [E]-Surgical Procedures, Operative [E04]
Gender: Female, Male. Age: 18-64 years. Enrolment: 120.
Status: Ongoing, recruiting. Start date (EU): 2020-09-09. Decision date: 2024-10-08. Results received: No. Last updated: 2024-10-08.

Condition(s): End-stage kidney disease in Type 1 diabetes, SIROLIMUS VERSUS MYCOPHENOLATE MOFETIL IN SIMULTANEOUS PANCREAS AND KIDNEY TRANSPLANTATION TO EVALUATE THE RISK OF HERNIA
Product: Rapamune 1 mg coated tablets, MYCOPHENOLATE MOFETIL

Primary endpoint: A new occurrence of an incisional hernia that is closely related to the transplantation procedure
Endpoint(s): A new occurrence of hernia in other localizations without relation to SPK surgery, A new occurrence of a lymphocele or other surgical complications (ureteral leak, bleeding, infection) whenever after transplantation, Patient and graft survival rates, Rejection rate (kidney, pancreas or both). A kidney or pancreas biopsy will be taken as clinically indicated in case of suspected rejection of either kidney or pancreas. Biopsy analysis will be done according to latest BANFF 2017 criteria, Treatment intolerance (permanent mycophenolate mofetil or sirolimus withdrawal for more than 40 days, Blood glucose and C-peptide levels (AUC) following a mixed meal test, average levels; blood glucose variability assessed a standard error of glucose levels registered using continuous glucose monitoring (CGM) with a subcutaneous glucose sensor, Creatinine clearance rate calculated by the CKD-EPI formula and glycosylated hemoglobin values, Progression of diabetic microangiopathic complication (retinopathy, neuropathy)

Source: https://euclinicaltrials.eu/ctis-public/view/2024-517391-38-00